EU clinical trial 2023-506429-13-00: An Open-Label, Single-Arm 4-Year Study to Evaluate Effectiveness and Safety of Ocrelizumab Treatment in Patients with Progressive Multiple Sclerosis
Protocol code: MN39159
Sponsor: F. Hoffmann-La Roche AG (Pharmaceutical company). Phase: Therapeutic confirmatory (Phase III). Countries: Netherlands (ended), Germany (ended), Denmark (ended), Poland (ongoing, recruitment ended), Czechia (ended), France (ongoing, recruitment ended), Italy (ongoing, recruitment ended).
Therapeutic area(s): Diseases [C] - Nervous System Diseases [C10]
Gender: Female, Male. Age: 18-64 years, 65+ years. Enrolment: 520.
Start date (EU): 2018-05-02. Decision date: 2024-03-18. Results received: No. Last updated: 2026-02-03.
Decision dates by country: CZ: 2024-03-18, DK: 2024-03-18, DE: 2024-03-18, NL: 2024-03-19, PL: 2024-04-16, FR: 2024-03-21, IT: 2024-03-18

Condition(s): Progressive multiple sclerosis (PMS)
Product: Methylprednisolone 500 mg powder and solvent for solution for injection/infusion, Ocrevus 300 mg concentrate for solution for infusion, Ocrevus 300 mg concentrate for solution for infusion, Paracetamol Accord 1000 mg comprimate efervescente, Diphenhydramine Hydrochloride Tablets 50 mg

Primary endpoint: 1. Proportion of patients with no evidence of progression (NEP) sustained for at least 24 weeks, 2. Proportion of patients with NEP and no active disease (NEPAD) sustained for at least 24 weeks
Endpoint(s): 1. Change from baseline in cognitive function as measured by the Symbol Digit Modalities Test (SDMT) and the Brief Visuospatial Memory Test – Revised (BVMT-R), 2. Change from baseline in the patient-reported outcomes including Multiple Sclerosis Impact Scale -29, Multiple Sclerosis Walking scale -12 items, ABILHAND-56 Questionnaire, Fatigue Scale for Motor and Cognitive (FSMC) function, SymptoMScreen, 88-item Multiple Sclerosis Spasticity Scale, Numerical Pain Rating Scale, Patient Global Impression of Severity (PGIS) for upper limb, lower limb and cognitive functions, 3. Mean change from baseline in the EDSS score over the course of the study, 4. Time to onset of first confirmed disability progression (as measured by EDSS) sustained for at least 24 and 48 weeks, 5. Time to onset of first >=20% increase in timed 25-foot walk test sustained for at least 24 weeks, 6. Time to onset of first >=20% increase in 9-hole peg test sustained for at least 24 weeks, 7. Proportion of patients with NEP, 8. Proportion of patients with NEPAD, 9. Proportion of patients with confirmed disability improvement (CDI) sustained for at least 24 weeks, 10. Change in the following MRI volumetric measures: whole brain volume, cerebral white matter volume change, cortical gray matter volume, deep grey matter volume, thalamic volumes, whole and regional cerebellar volume, 11. Change in the following lesion and tissue integrity parameters: - Number of new/enlarging T2 lesions and total T2 lesion volume - Number of T1 Gd+ lesions and total volume - Number of T1 lesions and total volume - Gd-enhancing fluid-attenuated inversion-recovery (FLAIR) meningeal lesions, 12. Rate and nature of adverse events, 13. Changes in clinical laboratory results, 14. Rates of study treatment discontinuation due to adverse events, 15. Change in the number of falls and near-falls

Source: https://euclinicaltrials.eu/ctis-public/view/2023-506429-13-00